EU clinical trial 2025-521150-42-00: A 40-week study comparing the efficacy, safety and patient-reported outcomes of once weekly IcoSema and once or twice daily insulin degludec/insulin aspart 100 units/mL, both treatment arms with or without oral anti-diabetic drugs, in participants with type 2 diabetes inadequately controlled with daily pre-mixed insulin. COMBINE 5
Protocol code: NN1535-8377
Sponsor: Novo Nordisk A/S (Pharmaceutical company). Phase: Therapeutic confirmatory (Phase III). Countries: Poland (ended).
Therapeutic area(s): Diseases [C] - Nutritional and Metabolic Diseases [C18]
Gender: Female, Male. Age: 18-64 years, 65+ years. Enrolment: 72.
Status: Ended. End date (EU): 2025-12-09. Decision date: 2025-12-09. Results received: Yes. Last updated: 2026-02-05.

Condition(s): Type 2 diabetes
Product: Ryzodeg 100 units/mL FlexTouch solution for injection in pre-filled pen, IcoSema 700 U/mL + 2 mg/mL PDS290

Primary endpoint: Change in HbA1c
Endpoint(s): Change in body weight, Number of clinically significant hypoglycaemic episodes (level 2) (<3.0 mmol/L (54 mg/dL), confirmed by BG meter) or severe hypoglycaemic episodes (level 3), Weekly insulin dose (total), Change in DTSQs total treatment satisfaction, Change in HbA1c, Change in mean 7-point SMPG profiles, Change in mean post-prandial glucose increment (over all meals), Time spent < 3.0 mmol/L (54 mg/dL), Time spent > 10.0 mmol/L (180 mg/dL), Change in time in range 3.9-10.0 mmol/L (70-180 mg/dL), Change in FPG, Change in Treatment Related Impact Measure - Diabetes (TRIM-D) score, Change in EQ-5D-5L score, Number of clinically significant hypoglycaemic episodes (level 2) (<3.0 mmol/L [54 mg/dL], confirmed by BG meter), Number of severe hypoglycaemic episodes (level 3)

Source: https://euclinicaltrials.eu/ctis-public/view/2025-521150-42-00